EU clinical trial 2024-515791-12-00: Pharmacokinetics of antibiotics in cerebrospinal fluid of children with external ventricular drain
Sponsor: Medical University Of Vienna (Educational Institution). Phase: Human Pharmacology (Phase I)- Other. Countries: Austria (ended).
Therapeutic area(s): Diseases [C] - Bacterial Infections and Mycoses [C01]
Gender: Female, Male. Age: 0-17 years. Enrolment: 56.
Status: Ended. Start date (EU): 2018-08-30. End date (EU): 2026-01-08. Decision date: 2024-09-08. Results received: Yes. Last updated: 2024-09-08.

Condition(s): patients with external ventricular drain
Product: Linezolid Kabi 2 mg/ml Infusionslösung, Vancomycin Hikma 500 mg - Pulver für ein Konzentrat zur Herstellung einer Infusionslösung, Cefuroxim „Astro“ - Trockenstechampulle, Kefzol 1 g – Trockenstechampullen, Piperacillin/Tazobactam Kabi 4 g/0,5 g Pulver zur Herstellung einer Infusionslösung , Gentamicin Sandoz 80 mg – Ampullen, Standacillin 1 g – Pulver zur Herstellung einer Injektions-/Infusionslösung

Primary endpoint: Maximum concentration (Cmax) in CSF, time to maximum concentration (tmax) in CSF, area under the concentration time curve from zero to last observed concentration (AUC0-τ) in CSF, half-life (t1/2) in CSF

Source: https://euclinicaltrials.eu/ctis-public/view/2024-515791-12-00